EU clinical trial 2024-514402-31-00: A Global, Multicenter, Single-arm, Matched External Control Study of Intrathecal SHP611 in Subjects with Late Infantile Metachromatic Leukodystrophy
Protocol code: SHP611-201
Sponsor: Shire Human Genetic Therapies Inc. (Pharmaceutical company). Phase: Therapeutic exploratory (Phase II). Countries: Germany (ended), France (ended), Belgium (ended), Greece (ended), Spain (ended), Italy (ended).
Therapeutic area(s): Diseases [C] - Nervous System Diseases [C10]
Gender: Female, Male. Age: 0-17 years. Enrolment: 10.
Status: Ended. Start date (EU): 2019-09-09. End date (EU): 2026-05-08. End date: 2026-05-09. Decision date: 2024-09-16. Results received: No. Last updated: 2025-09-23.
Decision dates by country: GR: 2024-09-20, IT: 2024-10-29, BE: 2024-09-16, ES: 2024-09-23, FR: 2024-09-26, DE: 2024-09-18

Condition(s): Late Metachromatic Leukodystrophy (MLD)
Product: rhASA

Primary endpoint: 01. The primary efficacy endpoint is time to loss of locomotion, measured by progression to GMFC-MLD category 5 or higher, or death, whichever occurs first, up to Week 106, evaluated on subjects in Group A.
Endpoint(s): 01. Response in Group A, defined as maintenance of gross motor function at Week 106, evaluated as subjects who do not experience any event within Week 106, where event is defined as a decline in GMFC MLD to category 5 or higher, or death, 02. Decline in gross motor function using GMFC MLD: - Change from baseline at Week 106 and EOS in gross motor function, using the GMFC MLD - Subjects with unreversed decline from baseline in GMFC-MLD of more than 2 categories, defined as any decline of more than 2-categories that has not reverted to a 2-category decline (or better) at Week 106, evaluated on subjects in Group A, 02. Decline in gross motor function using GMFC MLD: - Time to unreversed decline from baseline in GMFC-MLD of more than 2 categories, defined as any decline of more than 2-categories that has not reverted to a 2-category decline (or better) as of the last recorded observation, 03. Change from baseline at Week 106 and EOS in CSF sulfatides levels, 04. Response in Group A, defined as maintenance of gross motor function at Week 106, defined as a GMFM 88 total score ≥40, 05. Decline in gross motor function using GMFM-88: - Time to unreversed decline from baseline at Week 106 and EOS in GMFM-88 total score decrease of >20 points or unreversed decline to a score <40 points, whichever occurs first, 05. Decline in gross motor function using GMFM-88: - Change from baseline at Week 106 and EOS in gross motor function, using the GMFM-88 total score - Subjects in Group A with GMFM-88 total score decrease of ≤20 points from baseline and a total score that is ≥40 at Week 106 and EOS, 06. Change from baseline at Week 106 and EOS in expressive language using the ELFC-MLD

Source: https://euclinicaltrials.eu/ctis-public/view/2024-514402-31-00